EU clinical trial 2024-518281-27-00: A Phase I/II Open-label Dose Escalation and Dose Expansion Study to Evaluate the Safety, Pharmacokinetics, Pharmacodynamics, and Efficacy of AZD4360 in Adult Participants with Advanced Solid Tumours
Protocol code: D8930C00001
Sponsor: AstraZeneca AB (Pharmaceutical company). Phase: Phase I and Phase II (Integrated)- First administration to humans. Countries: Germany (ongoing, recruitment ended).
Therapeutic area(s): Diseases [C] - Neoplasms [C04]
Gender: Female, Male. Age: 18-64 years. Enrolment: 17.
Status: Ongoing, recruitment ended. Start date (EU): 2026-01-09. Decision date: 2025-09-11. Results received: No. Last updated: 2026-06-19.

Condition(s): Gastric Cancer, Gastroesophageal Junction Cancer, Biliary Tract Cancer, Pancreatic Ductal Adenocarcinoma
Product: AZD4360

Primary endpoint: Frequency of DLTs (dose escalation cohort), Incidence of AEs, SAEs, and AEs leading to discontinuation of AZD4360, Assess clinically significant changes in vital signs, laboratory parameters, and ECG results
Endpoint(s): Radiological response evaluated according to RECISTv1.1: Overall Response Rate, Duration of Response,Disease Control Rate, and Progression-free Survival, Overall Survival, Pharmamokinetics end points: Plasma concentration of AZD4360 total antibody and other analytes, Plasma PK parameters of AZD4360, total antibody andother analytes including but not limited to AUC, Cmax, tmax, clearance, and half-life, as data allow, Immunogenecitiy end point: Number and percentage of participants who develop ADA against AZD4360

Source: https://euclinicaltrials.eu/ctis-public/view/2024-518281-27-00